EU clinical trial 2024-515147-32-02: POSITRON - PsilOcybin with pSychologIcal supporT foR cOcaiNe: a randomised controlled pilot feasibility trial of psilocybin with psychological support for cocaine use disorder
Protocol code: TRI-CRF-23-02
Sponsor: Trinity College Dublin (Educational Institution). Phase: Therapeutic exploratory (Phase II). Countries: Ireland (authorised, recruitment pending).
Therapeutic area(s): Psychiatry and Psychology [F] - Mental Disorders [F03]
Gender: Female, Male. Age: 18-64 years. Enrolment: 24.
Status: Authorised, recruitment pending. Decision date: 2026-02-27. Results received: No. Last updated: 2026-07-08.

Condition(s): Cocaine addiction
Product: Nytol One-A-Night 50 mg Tablets, PSILOCYBIN (PEX010)

Primary endpoint: To assess feasibility of the clinical trial using psilocybin 25mg versus diphenhydramine 100mg (1:1) for the following: Recruitment methods and rate, Rate of willingness to be randomised, Randomisation, Adherence to follow-up, Reasons for drop-out from treatment and follow-up
Endpoint(s): Outcomes include: percentage of days abstinent (Timeline Followback & urine), sustained abstinence, time to relapse, cocaine craving (CCQ-Brief), mood/anxiety (DASS-21), functionality (Sheehan, EQ-5D-5L), psychedelic experience (5D-ASC, CEQ), treatment expectancy (SETS), blinding assessment, and meaning in life (MLQ)., Safety outcomes include: number of AEs and SAEs, ECG abnormalities (e.g., ischemia, MI, QTc >450ms for men, >470ms for women), clinically significant changes in blood pressure and heart rate during dosing (pre-dose, 1h, 3h, 6h), and lab tests (FBC, LFTs, U&E).

Source: https://euclinicaltrials.eu/ctis-public/view/2024-515147-32-02